EU clinical trial 2024-519009-36-01: Use of pegfilgrastim in severe chronic neutropenia
Protocol code: CDF 711
Sponsor: IRCCS Istituto Giannina Gaslini (Hospital/Clinic/Other health care facility). Phase: Therapeutic exploratory (Phase II). Countries: Italy (authorised, recruitment pending).
Therapeutic area(s): Diseases [C] - Hemic and Lymphatic Diseases [C15]; Diseases [C] - Immune System Diseases [C20]
Gender: Female, Male. Age: 0-17 years, 18-64 years. Enrolment: 20.
Status: Authorised, recruitment pending. Decision date: 2025-01-31. Results received: No. Last updated: 2025-01-31.

Condition(s): Severe chronic neutropenia (SCN)
Product: Neulasta 6 mg solution for injection

Primary endpoint: Median of absolute neutrophil count (from second to six months-period of study)
Endpoint(s): Number, type and duration of the infections (from second to six months-period of study), Number of antibiotic courses (from second to six months-period of study), Numbero of hospitalizations (from second to six months-period of study)

Source: https://euclinicaltrials.eu/ctis-public/view/2024-519009-36-01